EU clinical trial 2022-501780-41-00: Multicenter randomized controlled clinical trial comparing ebastine and mebeverine as treatment of irritable bowel syndrome
Sponsor: UZ Leuven (Hospital/Clinic/Other health care facility). Phase: Therapeutic confirmatory (Phase III). Countries: Belgium (ongoing, recruiting).
Therapeutic area(s): Diseases [C] - Digestive System Diseases [C06]
Gender: Female, Male. Age: 18-64 years. Enrolment: 200.
Status: Ongoing, recruiting. Start date (EU): 2023-05-17. Decision date: 2023-03-28. Results received: No. Last updated: 2025-11-20.

Condition(s): Irritable Bowel Syndrome
Product: Ebastine-dummy., Duspatalin Retard 200 mg capsules met verlengde afgifte, hard, EBASTINE TEVA 20 mg FILMTABLETTEN, Duspatalin-dummy

Primary endpoint: Abdominal Pain Intensity, Global Relief of Symptoms
Endpoint(s): Overall Response (Abdominal Pain Intensity & Global Relief of Symptoms): Weekly Responder for >= 6 weeks during the 12 weeks of treatment, Weekly Response up to Week 12, Weekly Response during Run-Out Period, Clinical Abdominal Pain Intensity Response: Abdominal Pain Intensity Weekly Responder for >= 3 weeks during the last 6 weeks of treatment, Overall Abdominal Pain Intensity Response: Abdominal Pain Intensity Weekly Responder for >= 6 weeks during the 12 weeks of treatment, Abdominal Pain Intensity Weekly Response up to Week 12, Weekly average Abdominal Pain Intensity Scores up to Week 12, %Change in weekly average Abdominal Pain Intensity Scores up to Week 12, Weekly average Abdominal Pain Intensity Scores during Run-Out period, Clinical Global Symptom Relief response: weekly responder for >= 3 weeks during the last 6 weeks of treatment, Overall Global Symptom Relief response: weekly responder for >= 6 weeks during the 12 weeks of treatment, Weekly Global Symptom Relief Response up to Week 12, Weekly Global Symptom Relief during Run-Out Period, Overall Stool Consistency Response: Stool Consistency Weekly responder for >= 6 weeks, Clinical Stool Consistency response: Stool Consistency Weekly Responder for >=3 weeks during the last 6 weeks of treatment, Stool Consistency Weekly Response up to Week 12, Weekly number of days with at least 1 stool of consistency 6 or 7 up to Week 12, Weekly number of days with at least 1 stool of consistency 6 or 7 during Run-Out Period, %Change in weekly number of days with at least 1 stool of consistency 6 or 7 up to Week 12, IBS-SSS score: score between 0 and 500 assessed at baseline and at 12 weeks; IBS-SSS Score and change in score at 12 weeks; IBS-SSS response: decrease >= 50 points, Quality of Life at Week 12

Source: https://euclinicaltrials.eu/ctis-public/view/2022-501780-41-00